EU clinical trial 2024-514501-57-00: A Phase 1/2, Multicenter, Open-Label Study to Investigate the Safety, Tolerability, and Efficacy of a Single Intravenous Dose of SGT-003 in Males with Duchenne Muscular Dystrophy
Protocol code: SGT-003-101
Sponsor: Solid Biosciences Inc. (Pharmaceutical company). Phase: Phase I and Phase II (Integrated)- First administration to humans. Countries: Italy (ongoing, recruiting).
Therapeutic area(s): Diseases [C] - Musculoskeletal Diseases [C05]
Gender: Male. Age: 0-17 years. Enrolment: 8.
Status: Ongoing, recruiting. Start date (EU): 2025-06-20. Decision date: 2025-01-27. Results received: No. Last updated: 2026-05-29.
Decision dates by country: IT: 2025-03-18

Condition(s): Duchenne muscular dystrophy

Primary endpoint: Incidence of treatment-emergent adverse events (AEs) through Day 360, Change from baseline of microdystrophin protein levels at Day 90
Endpoint(s): Change from baseline of microdystrophin tissue distribution at Day 90, Change from baseline of microdystrophin tissue distribution at Day 360, Change from baseline of microdystrophin protein levels at Day 360, Change from baseline in time to rise velocity at Day 360 and Day 540, Change from baseline in stride velocity 95th centile (SV95C) at Day 360 and Day 540, Change from baseline in 10-meter walk/run velocity at Day 360 and Day 540, Change from baseline in 4-stair climb velocity at Day 360 and Day 540, Change from baseline in the North Star Ambulatory Assessment (NSAA) score at Day 360 and Day 540, Change from baseline in 6-minute walk test (6MWT) distance at Day 360 and Day 540, Incidence of clinically significant laboratory abnormalities through Day 360 and Day 540, Incidence of clinically significant abnormalities in vital signs through Day 360 and Day 540, Incidence of clinically significant abnormalities in physical examinations through Day 360 and Day 540, Incidence of cardiac abnormalities by electrocardiogram (ECG) or echocardiography (ECHO) through Day 360 and Day 540

Source: https://euclinicaltrials.eu/ctis-public/view/2024-514501-57-00